EU clinical trial 2024-511370-72-00: A Phase II, Multicenter, Double-Blind, Randomised, Placebo-Controlled Study and Open-Label Long Term Extension to Evaluate the Safety and Efficacy of Elafibranor in Adult Participants with Primary Sclerosing Cholangitis (PSC)
Protocol code: CLIN-60190-453
Sponsor: Ipsen Bioscience Inc. (Pharmaceutical company). Phase: Therapeutic exploratory (Phase II). Countries: Spain (ongoing, recruitment ended), Italy (ongoing, recruitment ended), Germany (ongoing, recruitment ended), Portugal (ongoing, recruitment ended).
Therapeutic area(s): Phenomena and Processes [G] - Metabolism [G03]
Gender: Female, Male. Age: 18-64 years, 65+ years. Enrolment: 22.
Status: Ongoing, recruitment ended. Start date (EU): 2023-03-29. Decision date: 2024-08-21. Results received: No. Last updated: 2026-08-05.
Decision dates by country: DE: 2024-08-23, IT: 2024-09-04, PT: 2024-08-23, ES: 2024-08-21

Condition(s): Primary Sclerosing Cholangitis
Product: Placebo of Elafibranor, elafibranor, elafibranor

Primary endpoint: DBP: Number and percentage of participants who • experience TEAEs, treatment-related TEAEs, SAEs, and AESIs • develop clinically significant changes from baseline in physical examination findings, vital signs, and ECG • develop clinically significant changes from baseline in haematology, chemistry, liver tests, renal tests (including urinalysis), and other laboratory tests and procedures, OLE: Number and percentage of participants who • experience TEAEs, treatment-related TEAEs, SAEs, and AESIs • develop clinically significant changes from baseline in physical examination findings, vital signs and ECG • develop clinically significant changes from baseline in haematology, chemistry, liver tests, renal tests (including urinalysis), and other laboratory tests and procedures, OLE-LT: Number and percentage of participants who experience TEAEs, treatment related TEAEs, SAEs, and AESIs
Endpoint(s): DBP - objective 1: • Relative change from baseline in ALP at Week 12 • Number and percentage of participants with ≥40% decrease from baseline in ALP at Week 12 • Absolute change from baseline in ALP at Week 12 • Number and percentage of participants with ALP: <1.3x ULN and <1.5x ULN at Week 12, DBP - objective 1: • Number and percentage of participants who normalised ALP at Week 12 • Change from baseline in ALT, AST, GGT, 5’ nucleotidase, total bilirubin, conjugated bilirubin, albumin and fractionated ALP at Week 12, DBP - objective 2: • Change from baseline in ELF test at Week 12 • Change from baseline in LSM assessed by FibroScan ® at Week 12, DBP - objective 2: • Change from baseline in other non-invasive hepatic fibrosis serum markers as measured by PAI-1, TGF-β, marker of type V collagen formation (Pro-C5), and marker of type III collagen formation (Pro-C3) at Week 12 • Change from baseline in FIB-4 and APRI at Week 12 • Change from baseline in CK-18 (M65 and M30) at Week 12, DBP - secondary PK: • Individual PK parameters (during a dosing period of 24 hours) after single administration and at steady state: - AUC0-24 (area under the plasma concentration-time curve from time 0 to 24 hours) - Cmax (maximum (peak) plasma drug concentration) - Tmax (time to maximum plasma concentration), DBP - secondary PK: • Population PK parameters: - CL (apparent clearance of drug from plasma) - VZ (apparent volume of distribution), OLE: • Relative change from baseline in ALP at Week 52 and Week 96 of treatment in OLE • Number and percentage of participants with ≥40% decrease from baseline in ALP at Week 52 and Week 96 of treatment in OLE • Absolute change from baseline in ALP at Week 52 and Week 96 of treatment in OLE, OLE-LT: Number and percentage of participants who experience any of the following events: please check protocol

Source: https://euclinicaltrials.eu/ctis-public/view/2024-511370-72-00